EU clinical trial 2023-504427-61-01: BB trial; Effect of botox in Piriformis syndrome
Sponsor: Stichting Alrijne Zorggroep (Hospital/Clinic/Other health care facility). Phase: Therapeutic use (Phase IV). Countries: Netherlands (ended).
Therapeutic area(s): Diseases [C] - Musculoskeletal Diseases [C05]
Gender: Female, Male. Age: 18-64 years. Enrolment: 36.
Status: Ended. Start date (EU): 2024-03-07. End date (EU): 2026-02-24. Decision date: 2023-11-30. Results received: No. Last updated: 2023-11-30.

Condition(s): piriformis hypertonia
Product: physiological NaCl 0.9 %, BOTULINUM TOXIN TYPE A

Primary endpoint: Subjects that are withdrawn from treatment will be seen in the outpatient clinic 12 weeks after de test block.

Source: https://euclinicaltrials.eu/ctis-public/view/2023-504427-61-01